EU clinical trial 2024-512120-11-00: C4391001 - A PHASE 1/2A STUDY EVALUATING THE SAFETY, TOLERABILITY, PHARMACOKINETICS, PHARMACODYNAMICS, AND ANTI-TUMOR ACTIVITY OF PF-07220060 AS A SINGLE AGENT AND AS PART OF COMBINATION THERAPY IN PARTICIPANTS WITH ADVANCED SOLID TUMORS
Protocol code: C4391001
Sponsor: Pfizer Inc. (Pharmaceutical company). Phase: Phase I and Phase II (Integrated)- First administration to humans. Countries: Slovakia (ongoing, recruitment ended), Czechia (ongoing, recruitment ended).
Therapeutic area(s): Diseases [C] - Neoplasms [C04]
Gender: Female, Male. Age: 18-64 years, 65+ years. Enrolment: 62.
Status: Ongoing, recruitment ended. Start date (EU): 2022-08-31. Decision date: 2024-06-18. Results received: No. Last updated: 2026-06-30.
Decision dates by country: CZ: 2024-06-19, SK: 2024-06-18

Condition(s): Part 1B &1C; HR-positive/HER2-negative breast cancer, Part 2D mCRPC, Part 1F; Prostate cancer, Part 2A, 2B, 2C & 2E HR-positive /HER2-negative breast cancer, Part 1A/Part 1D/Part1E Breast cancer, NSCLC, prostate, CRC, liposarcoma, or tumors with previously confirmed CDK4 or CCND1 amplification.
Product: LETROZOLE, FULVESTRANT

Primary endpoint: Part 1A, Part 1B, Part 1C, and Part 1F: •DLTs observed during the DLT evaluation period. • AEs as characterized by type, frequency, severity (as graded by NCI CTCAE version 5.0), timing, seriousness, and relationship to study treatment. • Laboratory abnormalities as characterized by type, frequency, severity (as graded by NCI CTCAE version 5.0), and timing. •Incidence of clinically significant abnormal vital signs and ECG parameters., 1D: • PK parameters (Cmax, Tmax, AUClast, and as data permit, AUCinf, CL/F, Vz/F, and t1/2) of PF- 07220060 given with and without food. • AEs as characterized by type, frequency, severity (as graded by NCI CTCAE version 5.0), timing, seriousness, and relationship to study treatment. • Laboratory abnormalities as characterized by type, frequency, severity (as graded by NCI CTCAE version 5.0), and timing. •Incidence of clinically significant abnormal vital signs and ECG parameters., 1D: •PK parameters (Cmax, Tmax, AUClast, and as data permit, AUCinf, CL/F, Vz/F, and t1/2) of PF- 07220060 given with and without food. • AEs as characterized by type, frequency, severity (as graded by NCI CTCAE version 5.0), timing, seriousness, and relationship to study treatment. •Laboratory abnormalities as characterized by type, frequency, severity (as graded by NCI CTCAE version 5.0), and timing. •Incidence of clinically significant abnormal vital signs and ECG parameters., Part 1E: • PK parameters of CYP3A4 probe substrate midazolam with and without PF-07220060: Cmax, Tmax, AUClast, and as data permit, t½, AUCinf, CL/F and Vz/F. • AEs as characterized by type, frequency, severity (as graded by NCI CTCAE version 5.0), timing, seriousness, and relationship to study treatment., Part 1E: • Laboratory abnormalities as characterized by type, frequency, severity (as graded by NCI CTCAE version 5.0), and timing. • Incidence of clinically significant abnormal vital signs and ECG parameters., AEs as characterized by type, frequency, severity (as graded by NCI CTCAE version 5.0), timing, seriousness, and relationship to study treatment. • Laboratory abnormalities as characterized by type, frequency, severity (as graded by NCI CTCAE version 5.0, and timing.
Endpoint(s): Part 1A-1C and Part 1F (PF-07220060 PK) • Single dose: Cmax, Tmax, AUClast, and as data permit, AUCinf, CL/F, Vz/F, and t½., Part 1A-1C, Part 1E, and Part 1F (PF 07220060 PK) • Multiple dose (assuming steady state is achieved): Css,max Tss,max, AUCt,ss, Css,min, and as data permit, CLss/F, Vss/F, t½. and Rac (AUCt,ss/AUCt)., Part 1F (Enzalutamide + N-desmethyl enzalutamide PK) • Peak and trough concentrations of enzalutamide and N-desmethyl enzalutamide. • ORR and CBR as assessed using RECIST version 1.1 (Parts 1A-1E) or PCWG3 (Part 1F). • PSA50 rate (Part 1F). • Time-to-event endpoints: DOR and PFS (Parts 1A-1F)., Parts 2A, 2B, 2C, and 2E: • ORR and CBR as assessed using RECIST version 1.1. Time-to-event endpoints: DOR and PFS. • Peak and trough concentrations of PF-07220060., Part 2D: • ORR, DOR by PCWG3, PSA50 rate, rPFS, Time to first skeletal related events. • Symptoms and Health-Related Quality of Life as assessed by the FACT-P. • Peak and trough concentrations of PF-07220060, enzalutamide and N-desmethyl enzalutamide.

Source: https://euclinicaltrials.eu/ctis-public/view/2024-512120-11-00